EU clinical trial 2022-500201-41-00: (22081) Open-label, fixed sequence crossover study to determine the effects of a single dose of elinzanetant (BAY 3427080) on the pharmacokinetics of dabigatran etexilate in healthy participants
Protocol code: 22081
Sponsor: Bayer Consumer Care AG, Bayer AG (Pharmaceutical company). Phase: Human Pharmacology (Phase I)- Other. Countries: Germany (ended).
Therapeutic area(s): Diseases [C] - Hormonal diseases [C19]
Gender: Female, Male. Age: 18-64 years, 65+ years. Enrolment: 20.
Status: Ended. Start date (EU): 2022-08-02. End date (EU): 2022-11-14. End date: 2022-11-15. Decision date: 2022-07-28. Results received: Yes. Last updated: 2022-10-19.

Condition(s): Healthy volunteers (Vasomotor Symptoms as a sex hormone-dependent disorder in women and men)
Product: Pradaxa 75 mg hard capsules, BAY 3427080

Primary endpoint: Cmax of unconjugated and total dabigatran when given without or together with a single oral dose of EZN, AUC of unconjugated and total dabigatran when given without or together with a single oral dose of EZN, or AUC(0-tlast) if AUC cannot be determined in all participants
Endpoint(s): Number of participants with and severity of treatment-emergent adverse events (TEAEs)

Source: https://euclinicaltrials.eu/ctis-public/view/2022-500201-41-00